EU clinical trial 2024-515584-56-00: Optimization of skin preparation to reduce Cutibacterium acnes colonization in superficial and deep samples during prosthetic shoulder surgery in male patients (OPRICA)
Protocol code: RC19_0042
Sponsor: Centre Hospitalier Universitaire De Nantes (Hospital/Clinic/Other health care facility). Phase: Therapeutic confirmatory (Phase III). Countries: France (ongoing, recruiting).
Therapeutic area(s): Diseases [C] - Bacterial Infections and Mycoses [C01]
Gender: Male. Age: 18-64 years, 65+ years. Enrolment: 110.
Status: Ongoing, recruiting. Start date (EU): 2020-06-19. Decision date: 2024-10-21. Results received: No. Last updated: 2025-04-22.

Condition(s): Cutibacterium acnes infection in shoulder arthroplasty with males
Product: CUTACNYL 5 POUR CENT, gel pour application locale, BETADINE ALCOOLIQUE 5%, solution pour application cutanée en récipient unidose

Primary endpoint: Number of patients in each group (interventional: benzoyl peroxide 5% for 5 days or control) with a positive Cutibacterium acnes sample at the dermis.
Endpoint(s): Average number of positive intraoperative Cutibacterium acnes samples taken at the cutaneous level before and after cutaneous antisepsis of the operating area before incision, fat and capsular. The skin sample at inclusion will allow the initial cutaneous Cutibacterium acnes bacterial load to be compared between both groups, Average number of positive Cutibacterium acnes skin samples before and after alcoholic surgical site antisepsis (5% alcoholic iodine povidone) in each of the two study groups, Incidence of Cutibacterium acnes shoulder prosthesis infections up to 2 years after shoulder prosthesis implantation in both study groups, Determination of phylotype, molecular typing by Multi-Locus Sequence Typing and Single-Locus Sequence Typing techniques and comparison of Cutibacterium acnes strains by molecular biology and characterization of antibiotic resistance, Evaluation of the skin tolerance of the topical application from the local tolerance scale (irritation, erythema and desquamation), at the time of inclusion and at D0

Source: https://euclinicaltrials.eu/ctis-public/view/2024-515584-56-00